EU clinical trial 2024-513306-65-00: Safety and potential effect of innovative treatment by adjuvant injection of stromal vascular Fraction from autologous adipose tissue of URethral stenosis with endoscopic urethrotomy: randomized controlled trial
Protocol code: SURF
Sponsor: Centre Hospitalier Regional De Marseille (Hospital/Clinic/Other health care facility). Phase: Therapeutic exploratory (Phase II). Countries: France (temporarily halted).
Therapeutic area(s): Phenomena and Processes [G] - Reproductive and Urinary Physiological Phenomena [G08]; Diseases [C] - Male Urogenital Diseases [C12]
Gender: Male. Age: 18-64 years, 65+ years. Enrolment: 20.
Status: Temporarily halted. Start date (EU): 2024-03-13. Decision date: 2024-07-26. Results received: No. Last updated: 2024-07-26.

Condition(s): URethral stenosis
Product: SVF 8 inj prep, thawed SVF 8 inj prep

Primary endpoint: Safety endpoints will include the frequency and intensity of classic adverse events of urethrotomy: urethral bleeding, urinary infection, urethral pain (intensity and duration), and urethral perforation with fistula or perineal soft tissue infection.
Endpoint(s): Symptoms and quality of life using validated scale and questionnaires: ICIQ male LUTS (International Consultation on incontinence Questionnaire), USP (Urinary Symptom Profile) questionnaires and a PGII (Personnal Global impression of Improvement) scale, US examination: Uroflowmetry (Qmax in ml/s, voided volume in ml) and post voiding residual volume using ultrasound bladder scan., Recurrence occurring between 3 months and 24 months after the ADSVF injection and defined as a urinary retention or a decrease in uroflowmetry and quality of life equal to baseline situation ± 20% in a patient asking for a relief after an initial period of improvement (compare to baseline values), Volume of spongiofibrosis using MRI in Sagittal view in T1 Fat Sat after Gadolinium injection (reconstruction to evaluate total volume in mm3 of spongiofibrosis).

Source: https://euclinicaltrials.eu/ctis-public/view/2024-513306-65-00